EU clinical trial 2025-524744-36-00: DOXYCYCLINE PENETRATION INTO BONE AND JOINT.
Protocol code: 25-0320
Sponsor: Centre Hospitalier Universitaire De Caen Normandie (Hospital/Clinic/Other health care facility). Phase: Therapeutic exploratory (Phase II). Countries: France (authorised, recruitment pending).
Therapeutic area(s): Diseases [C] - Bacterial Infections and Mycoses [C01]
Gender: Female, Male. Age: 18-64 years, 65+ years. Enrolment: 30.
Status: Authorised, recruitment pending. Decision date: 2026-07-20. Results received: No. Last updated: 2026-07-20.

Condition(s): Patients requiring total hip arthroplasty for coxofemoral osteoarthritis
Product: DOXYCYCLINE BIOGARAN 100 mg, comprimé pelliculé sécable, DOXYCYCLINE ARROW 100 mg, comprimé pelliculé, DOXYCYCLINE TEVA 100 mg, comprimé sécable, DOXYCYCLINE SANDOZ 100 mg, comprimé sécable, GRANUDOXY 100 mg, comprimé pelliculé sécable

Primary endpoint: To measure doxycycline penetration in cancellous bone using the cancellous bone concentration/plasmatic concentration ratio
Endpoint(s): To mesure the concentration of Doxycycline in cortical bone using the cortical bone concentration/plasmatic concentration ratio, To measure the concentration of Doxycycline in synovial fluid using the synovial fluid concentration/plasmatic concentration ratio

Source: https://euclinicaltrials.eu/ctis-public/view/2025-524744-36-00